EU clinical trial 2025-520955-10-00: PRObiotic Therapy Examining Combinatorial Therapeutics in Multiple Sclerosis - phase II, multicenter, randomised, open-label clinical trial.
Protocol code: ABM/PROTECT-MS/2025
Sponsor: Wojskowy Instytut Medyczny Panstwowy Instytut Badawczy (Hospital/Clinic/Other health care facility). Phase: Therapeutic exploratory (Phase II). Countries: Poland (not authorised).
Therapeutic area(s): Diseases [C] - Nervous System Diseases [C10]; Diseases [C] - Immune System Diseases [C20]
Gender: Female, Male. Age: 18-64 years. Enrolment: 210.
Status: Not authorised. Decision date: 2025-10-20. Results received: No. Last updated: 2025-10-20.

Condition(s): Multiple sclerosis
Product: LACTOBACILLALES, Kesimpta 20 mg solution for injection in pre-filled syringe, Lacidofil, kapsułki, twarde, Kesimpta 20 mg solution for injection in pre-filled pen, Zeposia 0.92 mg hard capsules, Kesimpta 20 mg solution for injection in pre-filled syringe, Zeposia 0.23 mg hard capsules Zeposia 0.46 mg hard capsules, Zeposia 0.92 mg hard capsules, Kesimpta 20 mg solution for injection in pre-filled pen

Primary endpoint: Annualized Relapse Rate (ARR) at the end of month 12 and 24.
Endpoint(s): Percentage of patients with no clinical evidence of disease activity (NEDA) [Time Frame: Baseline month 12, month 24] NEDA is defined by no confirmed MS relapse, no new or enlarging T2 lesions, no Gadolinium-positive T1 lesions, and no six-month confirmed disability worsening., Mean Number of New or Enlarging Hyperintense T2-Weighted Brain Magnetic Resonance Imaging (MRI) Lesions Per Scan Over 24 Months [Time Frame: 24-month period]., The mean number of new or enlarging hyperintense T2-weighted brain MRI lesions per scan based on the cumulative number of new or enlarging T2 lesions since baseline over 24 months. [Time Frame: 24-month period]., Mean Number of Gadolinium Enhancing Brain Lesions at Month 12, Month 24 [Time Frame: 24-month period]., The number of gadolinium-enhancing (GdE) lesions at 12 month and 24 months. [Time Frame: 24-month period], Change in mental health evaluated by the GHQ-28 questionnaire in MS patients receiving Trilac vs Lacidofil vs the control group., Difference in severity of feeling pain measured by VAS scale in MS patients receiving Trilac vs Lacidofil vs the control group., Difference in severity of fatigue in MS patients receiving Trilac vs Lacidofil vs the control group. Fatigue will be evaluated by Fatigue Analogue Scale., Change in quality of life measured by SF-36 questionnaire in MS patients receiving Trilac vs Lacidofil vs the control group., Percentage of adverse events.

Source: https://euclinicaltrials.eu/ctis-public/view/2025-520955-10-00